EU clinical trial 2024-514309-73-00: A Phase 3, Multicenter, Double-Blind, Randomized, Placebo-Controlled Study of AG-120 in Combination with Azacitidine in Subjects ≥18 Years of Age with Previously Untreated Acute Myeloid Leukemia with an IDH1 Mutation
Protocol code: AG120-C-009
Sponsor: Institut De Recherches Internationales Servier IRIS (Pharmaceutical company). Phase: Therapeutic confirmatory (Phase III). Countries: Spain (ongoing, recruitment ended), Poland (ongoing, recruitment ended), Germany (ongoing, recruitment ended), France (ongoing, recruitment ended), Italy (ongoing, recruitment ended).
Therapeutic area(s): Diseases [C] - Hemic and Lymphatic Diseases [C15]
Gender: Female, Male. Age: 18-64 years, 65+ years. Enrolment: 76.
Status: Ongoing, recruitment ended. Start date (EU): 2018-02-06. Decision date: 2024-11-12. Results received: No. Last updated: 2026-08-03.
Decision dates by country: IT: 2024-11-18, DE: 2024-11-15, ES: 2024-11-12, PL: 2024-11-16, FR: 2024-11-13

Condition(s): Previously Untreated Acute Myeloid Leukemia with an IDH1 Mutation
Product: AG-120/S95031 250mg film-coated tablet, Placebo to Match AG-120 Tablet, 250 mg, is supplied as a film-coated tablet for oral administration., Vidaza 25 mg/ml powder for suspension for injection

Primary endpoint: The primary endpoint of the study is EFS, which is defined as the time from randomization until treatment failure, relapse from remission, or death from any cause, whichever occurs first. Treatment failure is defined as failure to achieve CR by Week 24.
Endpoint(s): • CR rate (CR defined as bone marrow blasts <5% and no Auer rods, absence of extramedullary disease, ANC ≥1.0 × 109/L [1000/µL], platelet count ≥100 × 109/L [100,000/µL], and independence of RBC transfusions). • OS, defined as the time from date of randomization to the date of death due to any cause., • CR + CRh rate (CRh is defined as a CR with partial recovery of peripheral blood counts where ANC is >0.5 × 109/L [500/µL], and platelet count is >50 × 109/L [50,000/µL]; CRh will be derived by the Sponsor). • ORR, defined as the rate of CR, CRi (including CRp), PR, and MLFS.

Source: https://euclinicaltrials.eu/ctis-public/view/2024-514309-73-00